EU clinical trial 2023-505841-22-00: A Phase 3, Randomized, Multicenter, Double-Blind, Placebo- and Active Comparator-Controlled Study to Evaluate the Efficacy, Safety, and Tolerability of TAK-279 in Subjects with Moderate-to-Severe Plaque Psoriasis
Protocol code: TAK-279-3001
Sponsor: Takeda Development Center Americas Inc. (Pharmaceutical company). Phase: Therapeutic confirmatory (Phase III). Countries: Poland (ended), Italy (ended), Germany (ended).
Therapeutic area(s): Diseases [C] - Skin and Connective Tissue Diseases [C17]
Gender: Female, Male. Age: 18-64 years, 65+ years. Enrolment: 235.
Status: Ended. Start date (EU): 2024-04-04. End date (EU): 2025-10-09. End date: 2025-10-22. Decision date: 2024-03-04. Results received: No. Last updated: 2025-12-10.
Decision dates by country: IT: 2024-03-11, DE: 2024-04-16, PL: 2024-03-07

Condition(s): Moderate to Severe Plaque Psoriasis
Product: Otezla 10mg, 20mg, 30 mg film-coated tablets, Otezla 10mg, 20mg, 30 mg film-coated tablets, Apremilast placebo (same excipient as over-encapsulated Otezla), Otezla 10mg, 20mg, 30 mg film-coated tablets, ZASOCITINIB, Otezla 30 mg film-coated tablets, TAK-279 placebo (same excipient as TAK-279)

Primary endpoint: Static Physician’s Global Assessment (sPGA) 0/1 response: Assessed as proportion of subjects achieving an sPGA of clear (0) or almost clear (1) with a ≥2-point decrease from baseline at Week 16., Psoriasis Area and Severity Index (PASI)-75 response: Assessed as proportion of subjects achieving ≥75% improvement from baseline in PASI score at Week 16.
Endpoint(s): PASI Response: Proportion of subjects achieving PASI-75 (versus apremilast), PASI-90, or PASI-100 at Week 16 or Week 24., Enhanced sPGA response: Proportion of subjects achieving an sPGA of clear (0) at Week 16, Changes in severity of psoriasis on the scalp, nail, body surface area, hands and feet using ssPGA, NAPSI, BSA, and PGA of the hands and/or feet

Source: https://euclinicaltrials.eu/ctis-public/view/2023-505841-22-00